EU clinical trial 2024-520231-33-00: A three-way cross-over phase IIa trial using L-citrulline and folic acid in combination with vericiguat and tadalafil in patients with treatment-resistant hypertension
Sponsor: Karolinska University Hospital (Hospital/Clinic/Other health care facility). Phase: Therapeutic exploratory (Phase II). Countries: Sweden (authorised, recruiting).
Therapeutic area(s): Diseases [C] - Cardiovascular Diseases [C14]
Gender: Female, Male. Age: 18-64 years, 65+ years. Enrolment: 21.
Status: Authorised, recruiting. Start date (EU): 2026-05-04. Decision date: 2025-07-17. Results received: No. Last updated: 2025-11-27.

Condition(s): Treatment-resistant hypertension
Product: Verquvo 2.5 mg film-coated tablets, Tadalafil Krka 5 mg filmdragerade tabletter, Folsyra Evolan 5 mg tablett

Primary endpoint: Change in systolic blood pressure (sBP) from baseline on combined citrulline, folic acid, vericiguat and tadalafil treatment versus combined citrulline, folic acid and vericiguat as measured by 24-hour ABPM.
Endpoint(s): Changes in office sBP from baseline, incidence of achieving target office sBP (<140 mmHg), diastolic blood pressure (dBP) from baseline, in office dBP from baseline, number of circulatory mature endothelial cells (CEC), as well as change in albumin/creatinine ratio in morning spot urine will be explored.

Source: https://euclinicaltrials.eu/ctis-public/view/2024-520231-33-00